EU clinical trial 2024-513059-33-00: A Randomized, Four-Way Change-over Study to Evaluate the Effect of Moderate Heat, Occlusion, and Moderate Exercise on the Pharmacokinetics and Tolerability of the Esflurbiprofen Topical System in Healthy Volunteers
Protocol code: TK-254RX-0104
Sponsor: Teikoku Seiyaku Co. Ltd. (Pharmaceutical company). Phase: Human Pharmacology (Phase I)- Other. Countries: Germany (ended).
Therapeutic area(s): Diseases [C] - Musculoskeletal Diseases [C05]
Gender: Female, Male. Age: 18-64 years. Enrolment: 28.
Status: Ended. Start date (EU): 2025-02-12. End date (EU): 2025-04-14. Decision date: 2024-12-18. Results received: No. Last updated: 2024-12-18.

Condition(s): bioavailability trial with healthy volunteers, therapeutical indication not studied

Source: https://euclinicaltrials.eu/ctis-public/view/2024-513059-33-00